EU clinical trial 2022-501817-29-00: A Phase 3, Randomized, Comparator-controlled Clinical Trial to Study the Efficacy and Safety of Pembrolizumab (MK-3475) in combination with Bacillus Calmette-Guerin (BCG) in Participants with High-risk Non-muscle Invasive Bladder Cancer (HR NMIBC) that is either Persistent or Recurrent Following BCG Induction or that is Naïve to BCG Treatment (KEYNOTE-676)
Protocol code: MK-3475-676
Sponsor: Merck Sharp & Dohme LLC (Pharmaceutical company). Phase: Therapeutic confirmatory (Phase III). Countries: Spain (ongoing, recruitment ended), France (ongoing, recruitment ended), Portugal (ongoing, recruitment ended), Finland (ongoing, recruitment ended), Italy (ongoing, recruitment ended), Germany (ongoing, recruitment ended), Netherlands (ongoing, recruitment ended), Austria (ongoing, recruitment ended), Poland (ongoing, recruitment ended), Hungary (ongoing, recruitment ended), Belgium (ongoing, recruitment ended), Greece (ongoing, recruitment ended), Norway (ongoing, recruitment ended).
Therapeutic area(s): Diseases [C] - Neoplasms [C04]
Gender: Female, Male. Age: 18-64 years, 65+ years. Enrolment: 559.
Status: Ongoing, recruitment ended. Start date (EU): 2018-11-27. Decision date: 2023-04-27. Results received: No. Last updated: 2026-07-27.
Decision dates by country: NL: 2023-05-01, BE: 2023-05-03, NO: 2023-05-02, FI: 2023-04-27, ES: 2023-04-27, IT: 2023-05-02, GR: 2023-05-17, HU: 2023-04-28, PT: 2023-04-28, DE: 2023-04-28, FR: 2023-04-27, PL: 2023-05-08, AT: 2023-05-02

Condition(s): High Risk Non-muscle invasive bladder cancer
Product: KEYTRUDA 25 mg/mL concentrate for solution for infusion, BACILLUS CALMETTE-GUÉRIN (BCG), TICE, BACILLUS CALMETTE-GUÉRIN (BCG), TICE

Primary endpoint: Complete Response Rate (CRR) by Blinded Independent Central Review (BICR) (Cohort A), Event-Free Survival (EFS) (Cohort B)
Endpoint(s): EFS (Cohort A), Recurrence-Free Survival (RFS) (Cohorts A and B), Overall Survival (OS) (Cohorts A and B), Disease Specific Survival (DSS) (Cohorts A and B), Time to Cystectomy (Cohorts A and B), 12-Month EFS Rate (Cohort A), Duration of Response (DOR) (Cohorts A and B), 12-Month DOR Rate (Cohorts A and B), Percentage of Participants Experiencing Adverse Events (AEs) (Cohorts A and B), Percentage of Participants Discontinuing Study Drug Due to AEs (Cohorts A and B), Change from Baseline in the European Organization for Research and Treatment of Cancer (EORTC)-Quality of Life Questionnaire-Core 30 (QLQ-C30) Global Health Status/Quality of Life (Items 29 and 30) Combined Score (Cohorts A and B), Change from Baseline in EORTC-QLQ-C30 Physical Functioning (Items 1-5) Combined Score (Cohorts A and B), Change from Baseline in EORTC-QLQ-Non-muscle Invasive Bladder Cancer Module 24 (NMIBC24) Total Score (Cohorts A and B), Change from Baseline in European Quality of Life (EuroQoL)-5 Dimensions, 5-level Questionnaire (EQ-5D-5L) Visual Analogue Score (VAS) (Cohorts A and B), Time to Deterioration (TTD) in the EORTC-QLQ-C30 Global Health Status/Quality of Life (Items 29 and 30) Combined Score (Cohorts A and B), TTD in the EQ-5D-5L VAS (Cohorts A and B), CRR by BICR (Cohort B), 24-Month EFS Rate (Cohort B)

Source: https://euclinicaltrials.eu/ctis-public/view/2022-501817-29-00